EU clinical trial 2022-501382-49-00: A Phase III, Randomized, Double-blind Study to Evaluate Pembrolizumab plus Chemotherapy vs Placebo plus Chemotherapy as Neoadjuvant Therapy and Pembrolizumab vs Placebo as Adjuvant Therapy for Triple Negative Breast Cancer (TNBC)
Protocol code: MK-3475-522
Sponsor: Merck Sharp & Dohme LLC (Pharmaceutical company). Phase: Therapeutic confirmatory (Phase III). Countries: Portugal (ended), Germany (ended), Poland (ended), France (ended), Spain (ended), Ireland (ended), Sweden (ended), Italy (ended).
Therapeutic area(s): Diseases [C] - Neoplasms [C04]
Gender: Female, Male. Age: 18-64 years, 65+ years. Enrolment: 439.
Status: Ended. Start date (EU): 2017-03-07. End date (EU): 2025-10-14. End date: 2025-10-15. Decision date: 2023-02-21. Results received: No. Last updated: 2025-08-25.
Decision dates by country: IE: 2023-02-21, SE: 2023-02-21, DE: 2023-02-27, ES: 2023-02-23, PT: 2023-02-24, FR: 2023-02-24, IT: 2023-02-24, PL: 2023-03-01

Condition(s): Triple Negative Breast Cancer (TNBC)
Product: CYCLOPHOSPHAMIDE, PEGFILGRASTIM, EPIRUBICIN, Placebo to keytruda-normal saline or dextrose, FILGRASTIM, DOXORUBICIN, PACLITAXEL, KEYTRUDA 25 mg/mL concentrate for solution for infusion, CARBOPLATIN

Primary endpoint: Pathological complete response (pCR) rate using the definition of ypT0/Tis ypN0 (i.e., no invasive residual in breast or nodes; noninvasive breast residuals allowed) at the time of definitive surgery, Event-free Survival (EFS) as assessed by Investigator
Endpoint(s): pCR rate using an alternative definition, ypT0 ypN0 (i.e., no invasive or noninvasive residual in breast or nodes) at the time of definitive surgery, pCR rate using the definition of ypT0/Tis ypN0 (i.e., no invasive residual in breast or nodes; noninvasive breast residuals allowed) at the time of definitive surgery, EFS in participants with tumors expressing PD-L1, pCR rate using an alternative definition, ypT0/Tis (i.e., absence of invasive cancer in the breast irrespective of ductal carcinoma in situ or nodal involvement) at the time of definitive surgery, Overall survival (OS), Percentage of participants who experience an adverse event (AE), Percentage of participants who discontinue study treatment due to an AE, European Organisation for Research and Treatment of Cancer (EORTC) Quality of Life Core 30 Questionnaire (QLQ-C30) score, EORTC Breast Cancer-Specific QoL Questionnaire (QLQ-BR23) score

Source: https://euclinicaltrials.eu/ctis-public/view/2022-501382-49-00